EU clinical trial 2024-513962-20-00: An Open-Label, Multicenter Study to Evaluate the Long-term Safety of Weekly Intravenous Alphal-Proteinase Inhibitor (Human), Modified Process 60 mg/kg in Subjects With Pulmonary Emphysema Due to Alpha1-Antitrypsin Deficiency
Protocol code: GTi1201_OLE
Sponsor: Grifols Therapeutics LLC (Pharmaceutical company). Phase: Therapeutic confirmatory (Phase III). Countries: Sweden (ongoing, recruitment ended), France (ended), Finland (ongoing, recruiting), Estonia (ended), Denmark (ongoing, recruitment ended), Poland (ongoing, recruiting).
Therapeutic area(s): Diseases [C] - Respiratory Tract Diseases [C08]
Gender: Female, Male. Age: 18-64 years, 65+ years. Enrolment: 120.
Start date (EU): 2016-07-14. Decision date: 2024-08-21. Results received: No. Last updated: 2026-07-20.
Decision dates by country: EE: 2024-08-23, FR: 2024-08-27, PL: 2024-09-16, SE: 2024-08-21, FI: 2024-08-21, DK: 2024-08-22

Condition(s): Pulmonary Emphysema due to Alpha-1-Antitrypsin Deficiency
Product: ALPHA-1-PROTEINASE INHIBITOR (HUMAN)

Primary endpoint: The efficacy variables that will be assessed are: •Whole lung 15th percentile point (PD15) using computed tomography (CT) densitometry •Carbon monoxide diffusing capacity (DLCO) •forced expiratory volume in 1 second (FEV1) •St. George’s Respiratory Questionnaire (SGRQ) score •Five level EQ-5D (EQ-5D-5L) score •Incidence and severity of chronic obstructive pulmonary disease (COPD) exacerbations as defined by American Thoracic Society (ATS)/European Respiratory Society (ERS) criteria
Endpoint(s): The following safety variables will be assessed in this study: •AEs, serious AEs (SAEs), and discontinuations due to AEs and SAEs •Physical examination (complete and respiratory) •Clinical laboratory parameters: hematology, chemistry (includes high-sensitivity C-reactive protein [hs-CRP])

Source: https://euclinicaltrials.eu/ctis-public/view/2024-513962-20-00